EU clinical trial 2024-516044-25-00: ASIC Channels and Migraine Disease - Proof-of-Concept Study on the Efficacy of Amiloride in Migraine Aura Prophylaxis
Protocol code: 16-API-01
Sponsor: Centre Hospitalier Universitaire De Nice (Hospital/Clinic/Other health care facility). Phase: Phase II and Phase III (Integrated). Countries: France (ongoing, recruiting).
Therapeutic area(s): Not possible to specify
Gender: Female, Male. Age: 18-64 years, 65+ years. Enrolment: 40.
Status: Ongoing, recruiting. Start date (EU): 2025-02-13. Decision date: 2024-10-17. Results received: No. Last updated: 2026-06-05.

Condition(s): Migraines with aura
Product: MODAMIDE 5 mg, comprimé, Tablets for oral use

Primary endpoint: Number of seizures with aura, with or without headache
Endpoint(s): Number of days with migraine headache, with or without aura, Number of days with any type of headache, with or without aura, Functional impact (impact score on HIT-6 scale), Emotional impact (anxiety and depression score on the HAD scale), Health status (EQ-5D scale score), Occurrence or absence of significant or unknown adverse events

Source: https://euclinicaltrials.eu/ctis-public/view/2024-516044-25-00